EU clinical trial 2024-517248-73-00: Effectiveness and safety of combined autologous Platelet Rich Plasma and Focal Shockwave Therapy for the treatment of erectile dysfunction
Sponsor: Boston Medical Group Spain S.L. (Hospital/Clinic/Other health care facility). Phase: Phase III and phase IV (Integrated). Countries: Spain (ongoing, recruiting).
Therapeutic area(s): Diseases [C] - Male Urogenital Diseases [C12]
Gender: Male. Age: 18-64 years. Enrolment: 116.
Status: Ongoing, recruiting. Start date (EU): 2024-08-19. Decision date: 2024-08-19. Results received: No. Last updated: 2024-08-19.

Condition(s): Erectile dysfunction
Product: PLATELET CONCENTRATE

Primary endpoint: Change in IIEF-EF score between baseline and week 21
Endpoint(s): Change in IIEF-EF score between baseline and week 13, Change in IIEF-EF score between baseline and week 33, Proportion of patients achieving the minimum clinically meaningful difference in IIEF-EF score (5 points), at weeks 13, 21, and 33, Change in EHS score between baseline and measurements at weeks 13, 21, and 33, Proportion of patients achieving vaginal penetration after treatment, as assessed by change in EHS from 1 or 2 at baseline to 3 or 4 at weeks 13, 21, and 33, Change in Sexual Quality of Life Questionnaire - SLQQ score between baseline and measurements at weeks 13, 21, and 33, Change in Global Assessment Questionnaire Score - GA at Weeks 13, 21, and 33, Incidence of PRP-related adverse events during the study.

Source: https://euclinicaltrials.eu/ctis-public/view/2024-517248-73-00